EU clinical trial 2024-517482-16-00: The dual orexin receptor antagonist daridorexant as an adjunct to improve buprenorphine maintenance therapy of opioid use disorder
Protocol code: BUDA
Sponsor: Linkopings Universitet (Educational Institution). Phase: Therapeutic exploratory (Phase II). Countries: Sweden (ongoing, recruiting).
Therapeutic area(s): Psychiatry and Psychology [F] - Mental Disorders [F03]
Gender: Female, Male. Age: 18-64 years. Enrolment: 192.
Status: Ongoing, recruiting. Start date (EU): 2025-04-04. Decision date: 2024-11-26. Results received: No. Last updated: 2026-02-09.

Condition(s): Opioid Use Disorder [OUD]
Product: Suboxone 8 mg/2 mg sublingual tablets, Film coated tablets matched to the test product as specified further in uploaded documents, Subutex 100 mg injektionsvätska, depotlösning, Subutex 300 mg injektionsvätska, depotlösning, QUVIVIQ 25 mg film-coated tablets

Primary endpoint: Frequency of negative urine samples (obtained weekly, with missing samples coded as positive) throughout weeks 1-13, supported by Time-Line Follow-Back (TLFB) self-report
Endpoint(s): Retention in treatment (survival), Opioid craving (OC-VAS; weekly), Opioid withdrawal (Subjective Opioid Withdrawal Scale, SOWS [weekly]), Substance-related problem severity and associated service needs (Addiction Severity Index, validated Swedish Self-report version, ASI-SR]) [monthly], Sleep quality (Pittsburgh Sleep Quality Index: PSQI) [weekly], Insomnia Severity Index (ISI]) [monthly], Level of functioning (WHODAS) [monthly]

Source: https://euclinicaltrials.eu/ctis-public/view/2024-517482-16-00